EU clinical trial 2023-508018-41-00: Extended Access of Momelotinib for Subjects with Primary Myelofibrosis (PMF) or Post-polycythemia Vera or Post-essential Thrombocythemia Myelofibrosis (Post-PV/ETMF)
Protocol code: SRA-MMB-4365/219627
Sponsor: Glaxosmithkline Research & Development Limited (Pharmaceutical company). Phase: Therapeutic exploratory (Phase II). Countries: Italy (ongoing, recruitment ended), Bulgaria (ongoing, recruitment ended), Denmark (ongoing, recruitment ended), Spain (ongoing, recruitment ended), Poland (ongoing, recruitment ended), Belgium (ongoing, recruitment ended), Hungary (ongoing, recruitment ended), France (ongoing, recruitment ended), Romania (ongoing, recruitment ended), Germany (ongoing, recruitment ended).
Therapeutic area(s): Diseases [C] - Neoplasms [C04]
Gender: Female, Male. Age: 18-64 years, 65+ years. Enrolment: 185.
Status: Ongoing, recruitment ended. Start date (EU): 2018-07-27. Decision date: 2024-07-02. Results received: No. Last updated: 2026-04-15.
Decision dates by country: IT: 2024-07-08, DE: 2024-07-03, RO: 2024-07-08, DK: 2024-07-02, BG: 2024-07-02, ES: 2024-09-23, BE: 2024-07-02, PL: 2024-07-15, HU: 2024-07-02, FR: 2024-07-05

Condition(s): Primary Myelofibrosis (PMF), Post-polycythemia Vera or Post-essential Thrombocythemia Myelofibrosis (Post-PV/ET MF)

Primary endpoint: Safety: Incidence, severity, seriousness, and causal relationship of AEs, as defined by CTCAE Version 4.03
Endpoint(s): Efficacy: overall survival (OS) and leukemia-free survival (LFS)

Source: https://euclinicaltrials.eu/ctis-public/view/2023-508018-41-00